EU clinical trial 2022-500921-34-00: A Phase I, Open-Label Study to Evaluate the Effect of Renal Impairment and Dialysis Treatment on the Pharmacokinetics of a Single 3 mg Cytisinicline Dose
Protocol code: ACH-CYT-05
Sponsor: Achieve Life Sciences Inc. (Pharmaceutical company). Phase: Human Pharmacology (Phase I)- Other. Countries: Portugal (ended), Spain (ended).
Therapeutic area(s): Psychiatry and Psychology [F] - Behavioral Disciplines and Activities [F04]
Gender: Female, Male. Age: 18-64 years, 65+ years. Enrolment: 56.
Status: Ended. Start date (EU): 2022-12-13. End date (EU): 2023-09-06. Decision date: 2022-10-24. Results received: Yes. Last updated: 2023-10-03.
Decision dates by country: PT: 2022-10-24, ES: 2022-10-26

Condition(s): Nicotine addiction
Product: Cytisinicline

Primary endpoint: Determination of cytisinicline plasma concentrations. Pharmacokinetic parameters: • Cmax • Tmax • Area under the plasma concentration versus time curve (AUC) from pre-dose (time zero) to the last sampling time with quantifiable concentrations (AUC0-t); • AUC0-∞ • Apparent terminal elimination rate constant (λz); • Apparent terminal elimination half-life (t1/2), • Fraction unbound (fu) • Apparent clearance (CL/F) • Apparent volume of distribution (V/F), Determination of cytisinicline urine concentrations. Pharmacokinetic parameters: • Amount of drug excreted in urine (Ae) • Fraction of unchanged drug excreted in urine (fe) • Area under the urine excretion rate curve from time zero to last measurable observed excretion rate (AURC) • Renal clearance (CLR) • Apparent nonrenal clearance (CLNR/F), Dialysate samples for determination of cytisinicline. Pharmacokinetic parameters: • Amount of drug recovered from each dialysate collection (AD) • Cumulative amount of drug recovered from the dialysate (AD, total) • Partial area under the curve estimated from predialyzer samples collected from start of dialysis (t0) to end of dialysis (t1) (AUCt0-t1) • Dialysis clearance (CLD) • Fraction of the administered dose that is recovered in the dialysate (Frem)
Endpoint(s): Safety will be evaluated through the assessment of adverse events (AEs), ECG, vital signs, and clinical laboratory tests.

Source: https://euclinicaltrials.eu/ctis-public/view/2022-500921-34-00